EU clinical trial 2024-512386-14-00: Proof of concept study to assess the efficacy and safety of Danicopan (factor D inhibitor) in adult patients with chronic spontaneous urticaria resistant to H1-antihistamine treatment (DANICSU).
Protocol code: TMP-08012024-3
Sponsor: Fraunhofer Institute For Translational Medicine And Pharmacology ITMP (Laboratory/Research/Testing facility). Phase: Therapeutic exploratory (Phase II). Countries: Germany (ended).
Therapeutic area(s): Diseases [C] - Skin and Connective Tissue Diseases [C17]
Gender: Female, Male. Age: 18-64 years, 65+ years. Enrolment: 24.
Status: Ended. End date (EU): 2024-10-20. Decision date: 2024-09-24. Results received: Yes. Last updated: 2024-09-24.

Condition(s): Chronic spontaneous urticaria
Product: MenQuadfi solution for injection Meningococcal Group A, C, W and Y conjugate vaccine, DANICOPAN, Bexsero suspension for injection in pre-filled syringe Meningococcal group B Vaccine (rDNA, component, adsorbed)

Primary endpoint: The change in baseline to week 17 in UAS7 for patients exhibiting low total IgE (≤40 kU/L) and patients with high total IgE levels (>40 kU/L).
Endpoint(s): Disease control: Urticaria Control Test (UCT) score and change to baseline; Angioedema Activity Score (AAS), score and change to baseline, percentage of patients with a positive UCT and AAS, respectively, Disease-specific quality of life: Dermatological Quality of Life Index, (DLQI), score and change to baseline; Chronic Urticaria Quality of Life Questionnaire ( CU-Q2oL), score and change to baseline; Angioedema Quality of Life Questionnaire (AE-QoL), score and change to baseline), Responder rates regarding UAS7 and UCT (none-, partial-, complete response), Rescue medication use (H1-AH, oral glucocorticoids) (substance and/or substance class)

Source: https://euclinicaltrials.eu/ctis-public/view/2024-512386-14-00